EU clinical trial 2024-515934-34-00: The use of Landiolol in mitral valve sUrgery: a raNdomized, controlled, double-blind triAl. (LUNA)
Protocol code: LUNA
Sponsor: Ospedale San Raffaele S.r.l. (Hospital/Clinic/Other health care facility). Phase: Therapeutic use (Phase IV). Countries: Italy (ongoing, recruiting).
Therapeutic area(s): Diseases [C] - Cardiovascular Diseases [C14]
Gender: Female, Male. Age: 18-64 years, 65+ years. Enrolment: 1500.
Status: Ongoing, recruiting. Start date (EU): 2025-01-28. Decision date: 2024-11-12. Results received: No. Last updated: 2026-05-20.

Condition(s): Low-cardiac output syndrome (LCOS)
Product: Landiobloc 300 mg polvere per soluzione per infusione, SODIO CLORURO 0,9% BAXTER Soluzione per infusione

Primary endpoint: The primary outcome will be the reduction of the occurrence of postoperative low-cardiac output syndrome, defined following a recent JAMA publication (Cholley 2017) as the presence of at least one of the following:, need of prolonged catecholamine infusion (persisting beyond 48 hours after the initiation of the study drug);, need of circulatory mechanical assist devices in the postoperative period (if an intraaortic balloon pump was inserted preventively, the criteria will be met if patients are not weaned from the balloon within 96 hours);, need for renal replacement therapy at any time during the intensive care unit stay.
Endpoint(s): Patients requiring prolonged (>48 h) catecholamine infusion;, patients with increased postoperative cardiac biomarkers (Troponin I or T);, patients with a reduction in left ventricular ejection fraction;, number of patients readmitted to hospital for cardiac reasons;, EQ-5D-5L questionnaire;, death.

Source: https://euclinicaltrials.eu/ctis-public/view/2024-515934-34-00